EU clinical trial 2024-517593-21-00: Dasatinib and quercetin, a combination of senolytics to treat fibrotic non-alcoholic fatty liver disease; The TRUTH study
Sponsor: Amsterdam UMC Stichting (Patient organisation/association). Phase: Therapeutic exploratory (Phase II). Countries: Netherlands (ended).
Therapeutic area(s): Diseases [C] - Nutritional and Metabolic Diseases [C18]; Diseases [C] - Digestive System Diseases [C06]
Gender: Female, Male. Age: 18-64 years, 65+ years. Enrolment: 30.
Status: Ended. Start date (EU): 2024-10-14. End date (EU): 2026-02-18. Decision date: 2024-10-14. Results received: No. Last updated: 2024-10-14.

Condition(s): MASLD, NAFLD
Product: CELLULOSE, MICROCRYSTALLINE, DASATINIB, QUERCETIN

Primary endpoint: The primary endpoint is the binary outcome improvement of fibrosis with at least 1-point without worsening of fibrosis and NAFLD score based on histology after 21 weeks (yes/no). Individuals will be labeled as responder or non-responder.
Endpoint(s): Mean change in number of senescent cells at baseline and end of treatment (week 21), Percent of patients with reversal of NAFLD (Steatosis without ballooning and with or without mild inflammation) and no worsening of fibrosis) from baseline to end of treatment (week 21)., Global hepatic mRNA expression baseline to end of treatment (week 21), Change from baseline to week 21 in NAFLD activity score (NAS), Activity component of steatosis-activity-fibrosis (SAF) score: steatosis -1 point, lobular inflammation -1 point, ballooning -1 point EPOS score a 7 item scoring system (0-6) which represent the seven stages of fibrosis., Change from baseline to week 21 in: Fibrosis-4 score (Fib-4 score) and NAFLD Fibrosis Score (NFS) Liver enzymes and synthesis function: ALT, AST and yGT, albumin, INR Liver stiffness and liver steatosis (with controlled attenuation parameter) measurement by Fibroscan, Change from baseline to 21 weeks in: Glycosylated haemoglobin type A1c (HbA1c), Fasting plasma glucose (FPG), Fasting insulin and glucagon , Homeostatic model assessment of insulin resistance (HOMA-IR) , Glucose day curve (Freestyle libre), Change from baseline to 21 weeks in: RAND-36 and EQ-5D-5L: physical and mental component summary scores and scores on the individual sub-domains: Physical functioning, role functioning, bodily pain, general health, vitality, social functioning, role emotional and mental health., Safety endpoints, Change from baseline to 21 weeks in: Pulse and ECG , Physical examination ,Haematology (haemoglobin, thrombocytes, erythrocytes, leucocytes, differential count) , Biochemistry (creatinine, creatinine phosphokinase, urea, bilirubin (total), alkaline phosphatase, ferritin, sodium, potassium, calcium. Fecal microbiota composition (morning stool and bile acids)

Source: https://euclinicaltrials.eu/ctis-public/view/2024-517593-21-00